EU clinical trial 2023-505617-24-00: A Randomized Phase 2 Study of Ocular Toxicity Evaluation and Mitigation During Treatment with Mirvetuximab Soravtansine in Patients with Recurrent Ovarian Cancer with High Folate Receptor-Alpha Expression
Protocol code: IMGN853-0424
Sponsor: AbbVie Deutschland GmbH & Co. KG (Pharmaceutical company). Phase: Therapeutic exploratory (Phase II). Countries: Spain (ongoing, recruitment ended), France (ongoing, recruitment ended), Ireland (ongoing, recruitment ended), Belgium (ongoing, recruitment ended).
Therapeutic area(s): Diseases [C] - Neoplasms [C04]
Gender: Female. Age: 18-64 years, 65+ years. Enrolment: 46.
Status: Ongoing, recruitment ended. Start date (EU): 2024-11-05. Decision date: 2024-06-06. Results received: No. Last updated: 2026-06-05.
Decision dates by country: BE: 2024-07-05, IE: 2024-07-18, ES: 2024-06-06, FR: 2024-07-02

Condition(s): Recurrent Ovarian Cancer with High Folate Receptor-Alpha Expression
Product: Mirvetuximab Soravtansine, Pred Forte 10 mg/ml colirio en suspensión, Brimonidine Tartrate 0.2% w/v Eye Drops., Pred Forte 1% w/v, Eye Drops Suspension, Alphagan 2 mg/ml colirio en solución

Primary endpoint: The incidence rate and severity of MIRV-related corneal TEAEs (≥ Grade 2) in asymptomatic patients (defined as ocular symptom assessment ≤ Grade 1) with recurrent ovarian cancer with high FRα expression, assessed up to 18 weeks from Cycle 1 Day 1 (C1D1) or at the 30-Day Follow-up visit, whichever is earlier
Endpoint(s): The incidence rate and severity of ocular symptom TEAEs in patients using corticosteroid or vasoconstricting eye drop primary prophylaxis assessed up to 18 weeks from C1D1 or at the 30-Day Follow-up visit, whichever is earlier, The incidence rate and severity of MIRV-related corneal TEAEs (≥ Grade 2) in symptomatic patients on ophthalmic assessment up to 18 weeks from C1D1 or at the 30-Day Follow-up visit, whichever is earlier, The incidence rate and severity of all MIRV-related corneal TEAEs (≥ Grade 2) in patients using corticosteroid or vasoconstricting eye drop primary prophylaxis assessed up to 18 weeks from C1D1 or at the 30-Day Follow-up, whichever is earlier, Use of the composite score of the NEI VFQ-25 to evaluate ocular HRQoL and patient-reported outcomes at C5D1 or at the 30-Day Follow-up visit, whichever is earlier, PK concentrations, including pre-dose and end-of-infusion plasma concentration in asymptomatic and symptomatic patients in both prophylaxis groups, The incidence rate and severity of ocular exam TEAEs in asymptomatic and symptomatic patients on ophthalmic assessment up to 18 weeks from C1D1 or at the 30-Day Follow-up visit, whichever is earlier, The incidence rate and severity of ocular exam TEAEs in patients using corticosteroid or vasoconstricting eye drop primary prophylaxis up to 18 weeks from C1D1 or at the 30‑Day Follow-up visit, whichever is earlier

Source: https://euclinicaltrials.eu/ctis-public/view/2023-505617-24-00